EU clinical trial 2024-515363-63-00: (BIPAS) A prospective trial to assess Pneumococcal vaccine B cell response in patients without a spleen: a controlled study.
Protocol code: 2024-515363-63-00
Sponsor: Leids Universitair Medisch Centrum (LUMC) (Hospital/Clinic/Other health care facility). Phase: Therapeutic use (Phase IV). Countries: Netherlands (ongoing, recruiting).
Therapeutic area(s): Diseases [C] - Bacterial Infections and Mycoses [C01]; Phenomena and Processes [G] - Immune system processes [G12]; Diseases [C] - Immune System Diseases [C20]
Gender: Female, Male. Age: 18-64 years, 65+ years. Enrolment: 70.
Status: Ongoing, recruiting. Start date (EU): 2025-11-07. Decision date: 2025-08-11. Results received: No. Last updated: 2025-08-11.

Condition(s): Asplenia
Product: CAPVAXIVE solution for injection in pre-filled syringe Pneumococcal polysaccharide conjugate vaccine (21-valent), Prevenar 20 suspension for injection in pre-filled syringe Pneumococcal polysaccharide conjugate vaccine (20-valent, adsorbed)

Primary endpoint: Mean Fold change of PS specific IgG GMCs against PS present in PCV20 and PCV21 (common serotypes) 2-3 weeks after booster vaccination with PCV21, at least 12 months after primary vaccination with PCV20 in asplenic patients primed before or after splenectomy.
Endpoint(s): Difference in height of PS-specific IgG GMCs and PS-specific IgG B cell response, % of participants with a >2 and >4 fold change 3 weeks after primary and 2-3 weeks after booster, compared to primary vaccination before and after splenectomy and with healthy controls, for PS present in both vaccines (common serotypes) and unique for PCV21, PS-specific IgM GMC persistence at 12 after primary and 6-12 months after booster, for PS present in both vaccines (common serotypes) and unique for PCV21, Correlation between IgG GMC height and PS-specific IgG memory B cell count 3 weeks after primary and 2-3 weeks after booster, for PS present in both vaccines (common serotypes) and unique for PCV21, Mean fold change of PS specific IgG GMCs 2-3 weeks after PCV21 vaccination, for PS unique in PCV21.

Source: https://euclinicaltrials.eu/ctis-public/view/2024-515363-63-00